EU clinical trial 2024-511366-36-00: The effect of systemic antibiotics on post-surgical complications and patient-centered outcomes in patients undergoing implant surgery with guided bone regeneration and simultaneous sinus floor elevation
Sponsor: Medical University Of Graz (Educational Institution). Phase: Therapeutic use (Phase IV). Countries: Austria (ongoing, recruitment ended).
Therapeutic area(s): Diseases [C] - Bacterial Infections and Mycoses [C01]; Analytical,Diagnostic,Therapeutic Techniques and Equipment [E]-Surgical Procedures, Operative [E04]; Analytical, Diagnostic and Therapeutic Techniques and Equipment [E] - Dentistry [E06]
Gender: Female, Male. Age: 18-64 years, 65+ years. Enrolment: 30.
Status: Ongoing, recruitment ended. Start date (EU): 2022-12-29. Decision date: 2024-09-08. Results received: No. Last updated: 2025-04-10.

Condition(s): implant surgery with guided bone regeneration and simultaneous sinus floor elevation
Product: Moxilen 500 mg hard capsules, Amylium Maydis

Primary endpoint: Patient Reported Outcome Measures (PROMs): Visual analogue scores VAS (0-10) on the wound (bleeding, swelling, pain, bruising (haematoma)) and discomfort of the sinuses (nosebleed, nasal congestion, rhinorrhea (excessive nasal discharge including posterior nasal drip), feeling of pressure, hyposmia (reduction in smell)) on days 1-7 & 14 .
Endpoint(s): Clinical recordings of post-surgical complications at week 2, 4, 16-20 and 6 months after crown- installation on: flap closure/dehiscence, pain/sensitivity on palpation, swelling (obliteration of the sulcus), suppuration/purulent discharge, Implant stability (at initial placement and 2nd stage surgery).

Source: https://euclinicaltrials.eu/ctis-public/view/2024-511366-36-00